EU clinical trial 2023-508953-16-00: A Pilot and Surgical Study of Larotrectinib for Treatment of Children with Newly Diagnosed High-Grade Glioma with NTRK Fusion
Protocol code: CONNECT1903
Sponsor: Nationwide Childrens Hospital (Hospital/Clinic/Other health care facility). Phase: Therapeutic exploratory (Phase II). Countries: Germany (ongoing, recruiting).
Therapeutic area(s): Diseases [C] - Neoplasms [C04]
Gender: Female, Male. Age: 0-17 years, 18-64 years. Enrolment: 5.
Status: Ongoing, recruiting. Start date (EU): 2024-10-25. Decision date: 2024-05-15. Results received: No. Last updated: 2026-04-09.

Condition(s): Newly diagnosed high grade glioma (HGG) including diffuse intrinsic pontine glioma (DIPG)
Product: METHOTREXATE, CYCLOPHOSPHAMIDE MONOHYDRATE, Larotrectinib Bayer, Larotrectinib Bayer, ETOPOSIDE PHOSPHATE, CARBOPLATIN, Larotrectinib Bayer, VINCRISTINE SULFATE

Primary endpoint: Disease control rate (CR, CCR, PR, SD) presented as frequency and percentage. Time frame: At the end of cycle 2, Number of participants with treatment-related adverse events as assessed by CTCAE v5.0. Time frame: From Day 1 of Course 1 of combination treatment with chemotherapy/ from Day 1 of treatment after radiotherapy through 30 days following end of protocol treatment

Source: https://euclinicaltrials.eu/ctis-public/view/2023-508953-16-00